EU clinical trial 2023-504676-17-00: APEDOC: The role of peripheral afferents in modulating post-stroke central pain
Protocol code: C23-05
Sponsor: Institut National De La Sante Et De La Recherche Medicale (Laboratory/Research/Testing facility). Phase: Therapeutic confirmatory (Phase III). Countries: France (ongoing, recruiting).
Therapeutic area(s): Diseases [C] - Nervous System Diseases [C10]
Gender: Female, Male. Age: 18-64 years, 65+ years. Enrolment: 30.
Status: Ongoing, recruiting. Start date (EU): 2025-01-06. Decision date: 2023-08-02. Results received: No. Last updated: 2026-02-26.

Condition(s): Patients with central neuropathic pain POST stroke

Source: https://euclinicaltrials.eu/ctis-public/view/2023-504676-17-00